EU clinical trial 2022-502856-29-00: A Modular Phase I/IIa, Open-label, Multicentre Study to Assess the Safety, Tolerability, Pharmacokinetics, Pharmacodynamics and Preliminary Efficacy of Ascending Doses of AZD5305 as Monotherapy and in Combination with Anti-cancer Agents in Patients with Advanced Solid Malignancies (PETRA)
Protocol code: D9720C00001
Sponsor: AstraZeneca AB (Pharmaceutical company). Phase: Phase I and Phase II (Integrated)- First administration to humans. Countries: Spain (ongoing, recruitment ended), Poland (ongoing, recruitment ended), Italy (ongoing, recruitment ended), Czechia (ongoing, recruitment ended), Hungary (ongoing, recruitment ended).
Therapeutic area(s): Diseases [C] - Neoplasms [C04]
Gender: Female, Male. Age: 18-64 years, 65+ years. Enrolment: 427.
Status: Ongoing, recruitment ended. Start date (EU): 2021-07-27. Decision date: 2024-05-20. Results received: No. Last updated: 2026-06-17.
Decision dates by country: HU: 2024-05-21, PL: 2024-05-27, IT: 2024-05-28, CZ: 2024-05-21, ES: 2024-05-20

Condition(s): Advanced Solid Tumors
Product: Saruparib, Saruparib, Saruparib, PACLITAXEL, DS-8201a, Saruparib, Datopotamab deruxtecan, Camizestrant

Primary endpoint: Safety and tolerability will be assessed by the presence of AEs, SAEs, DLTs, MTD, physical examination changes from baseline, ECOG changes from baseline, and changed from baseline in laboratory findings, vital signs, and ECG results.
Endpoint(s): Plasma concentrations of AZD5305 and plasma PK parameters, including but not limited to AUC, Cmax and Tmax as data allow, of AZD5305 after single dose and multiple doses administration., Radiological response evaluated according to response evaluation criteria in solid tumours (RECIST v1.1) a) Best percentage change in target lesion b) ORR, DoR, PFS, TTR., For ovarian cancer patients, CA125 response evaluated according to the GCIG criteria., For prostate cancer patients, PSA50 response and ORR and rPFS using RECIST 1.1 and PCWG3 criteria., Includes, but is not limited to assessment pH2AX (Ser139) PD G58biomarker modulations at baseline visit 1 and during treatment and other module specific biomarker., Plasma and urine concentrations and PK parameters of AZD5305 and paclitaxel after single dose and multiple doses administration, including, but not limited to AUC, Cmax and Tmax, as data allow., To investigate the effect of a high-fat meal on the PK of AZD5305., Total plasma concentration and PK parameters, as data allow, of carboplatin during and after infusion., Plasma concentrations and PK parameters of T-DXd (T-DXd, total anti-HER2 antibody and MAAA-1181a) after single dose and multiple dose administration, including, but not limited to AUC, Cmax and Tmax, as data allow., Plasma concentrations and PK parameters of Dato-DXd, total anti TROP2 antibody, and MAAA-1181a (payload) including, but not limited to AUC, Cmax and Tmax, as data allow., Plasma concentrations and PK parameters of AZD5305 and camizestrant after single dose and multiple dose administration, including, but not Q53limited to: AUC, Cmax, Tmax, as data allow.

Source: https://euclinicaltrials.eu/ctis-public/view/2022-502856-29-00